EU clinical trial 2025-525076-29-00: Crossover study to investigate the safety and tolerability as well as the blood levels after three single doses of Tacrolimus, of which 2 are administered via the cheek mucosa and 1 dose via the mouth (oral).
Protocol code: PETRA-MBF2
Sponsor: Nucleus Medical GmbH (Pharmaceutical company). Phase: Human Pharmacology (Phase I)- Other. Countries: Germany (ended).
Therapeutic area(s): Phenomena and Processes [G] - Immune system processes [G12]
Gender: Male. Age: 18-64 years. Enrolment: 6.
Status: Ended. Start date (EU): 2026-03-23. End date (EU): 2026-05-06. Decision date: 2026-03-04. Results received: No. Last updated: 2026-03-04.

Condition(s): Phase I study in healthy male volunteers. Intended indication: prophylaxis of transplant rejection in liver, kidney or heart allograft recipients and for treatment of allograft rejection

Source: https://euclinicaltrials.eu/ctis-public/view/2025-525076-29-00